EU clinical trial 2024-514233-37-00: Sentinel lymph node biopsy in patients with parotid gland carcinoma using a combination of 99mTc-nanocolloid and 68Ga-tilmanocept PET/CT: A feasibility study. (SNparotis)
Sponsor: Universitair Medisch Centrum Utrecht (Hospital/Clinic/Other health care facility). Phase: Therapeutic confirmatory (Phase III). Countries: Netherlands (ongoing, recruiting).
Therapeutic area(s): Analytical,Diagnostic,Therapeutic Techniques and Equipment [E]-Surgical Procedures, Operative [E04]
Gender: Female, Male. Age: 18-64 years, 65+ years. Enrolment: 10.
Status: Ongoing, recruiting. Start date (EU): 2024-07-12. Decision date: 2024-07-12. Results received: No. Last updated: 2024-07-12.

Condition(s): Carcinoma of the parotid gland
Product: GALLIUM (68GA) CHLORIDE, TILMANOCEPT

Primary endpoint: Primary endpoint is the feasibility of the sentinel lymph node biopsy (SLNB) procedure in patients with carcinoma of the parotid gland with a clinically negative neck scheduled for parotidectomy with elective neck dissection. Detection of SLNs, using 68Ga-tilmanocept PET/CT lymphoscintigraphy, is considered feasible, if 68Ga-tilmanocept PET/CT lymphoscintigraphy is able to depict SLNs in at least 8 out of 10 patients and excise the SLNs peroperatively.
Endpoint(s): To compare histopathologic results (presence or absence of isolated tumour cells and (micro-)metastasis) of the excised sentinel lymph node(s), and elective neck dissection specimens. To investigate in which levels the sentinel lymph nodes are localized and the number of sentinel lymph nodes. To investigate the best timing of PET/CT. The incidence and degree of postoperative complications, graded by means of the Clavien-Dindo classification of Surgical Complications

Source: https://euclinicaltrials.eu/ctis-public/view/2024-514233-37-00